EU clinical trial 2025-523793-16-00: A Phase 2, Multicenter, Randomized, Placebo-controlled, Double-blind Study of the Efficacy and Safety of Vamifeport in Adult Subjects with HFE-related Hereditary Hemochromatosis (FERROCLEAR Study)
Protocol code: CSL624_2001
Sponsor: CSL Behring LLC (Pharmaceutical company). Phase: Therapeutic exploratory (Phase II). Countries: Austria (authorised, recruitment pending), Poland (authorised, recruitment pending), Spain (ongoing, recruiting), Germany (authorised, recruitment pending), France (ongoing, recruiting), Ireland (authorised, recruitment pending), Romania (authorised, recruitment pending), Belgium (authorised, recruitment pending), Italy (authorised, recruitment pending), Czechia (ongoing, recruiting), Netherlands (authorised, recruitment pending).
Therapeutic area(s): Diseases [C] - Congenital, Hereditary, and Neonatal Diseases and Abnormalities [C16]
Gender: Female, Male. Age: 18-64 years, 65+ years. Enrolment: 50.
Start date (EU): 2026-07-15. Decision date: 2026-04-20. Results received: No. Last updated: 2026-07-13.
Decision dates by country: AT: 2026-04-27, BE: 2026-04-22, CZ: 2026-04-21, NL: 2026-04-20, PL: 2026-04-23, FR: 2026-04-23, DE: 2026-04-21, IT: 2026-04-27, RO: 2026-04-27, ES: 2026-04-27, IE: 2026-04-24

Condition(s): Homeostatic iron regulator gene-related hereditary hemochromatosis
Product: CSL624, Capsule (placebo matching vamifeport)

Primary endpoint: Change from baseline in magnetic resonance imaging (MRI)-based liver iron concentration (LIC) ,

Source: https://euclinicaltrials.eu/ctis-public/view/2025-523793-16-00